EU clinical trial 2024-517831-28-00: Monitoring of neuromuscular blockade during general anaesthesia after reversal with neostigmine
Sponsor: Pirkanmaan hyvinvointialue (Hospital/Clinic/Other health care facility). Phase: Therapeutic use (Phase IV). Countries: Finland (ongoing, recruiting).
Therapeutic area(s): Analytical, Diagnostic and Therapeutic Techniques and Equipment [E] - Anesthesia and Analgesia [E03]
Gender: Female, Male. Age: 18-64 years. Enrolment: 120.
Status: Ongoing, recruiting. Start date (EU): 2025-01-01. Decision date: 2024-09-17. Results received: No. Last updated: 2024-09-17.

Condition(s): Incidence of reappearance of the muscle relaxation after reversal with neostigmine
Product: GLYCOSTIGMIN -injektioneste, liuos

Primary endpoint: To find the incidence of reappearance of nondepolarizing neuromuscular block after reversal with neostigmine

Source: https://euclinicaltrials.eu/ctis-public/view/2024-517831-28-00